EU clinical trial 2023-506144-16-00: A First-in-Human, Open-label, Phase 1/2 Study to Evaluate the Safety, Pharmacokinetics, Pharmacodynamics, and Clinical Activity of JNJ-63723283, an Anti-PD-1 Monoclonal Antibody, in Subjects with Advanced Cancers
Protocol code: 63723283LUC1001
Sponsor: Janssen - Cilag International (Pharmaceutical company). Phase: Phase I and Phase II (Integrated)- First administration to humans. Countries: Spain (ended), Poland (ongoing, recruitment ended).
Therapeutic area(s): Diseases [C] - Neoplasms [C04]
Gender: Female, Male. Age: 18-64 years, 65+ years. Enrolment: 3.
Start date (EU): 2016-12-06. Decision date: 2024-07-16. Results received: No. Last updated: 2026-02-16.
Decision dates by country: ES: 2024-07-16, PL: 2024-07-22

Condition(s): Advanced Stage Solid Tumors
Product: cetrelimab, JNJ-63723283

Primary endpoint: Frequency and severity of DLT (Part 1); Overall response rate per the RECIST version 1.1 in subjects with selected advanced solid tumors (Part 2); JNJ-63723283 PK parameters after 1st dose administration as observed in Part 3 and JNJ-63723283 PK parameters after 4th dose as observed during Q3W dosing in Part 4

Source: https://euclinicaltrials.eu/ctis-public/view/2023-506144-16-00